EU clinical trial 2024-516028-33-01: (CAbotégravir LENacapavir DUal Long Acting). Phase II, Pilot study, open label, multicenter, evaluating dual antiretroviral therapy with long-acting cabotegravir/lenacapavir IMEA 069 - CALENDULA
Sponsor: Inst Medecine Epidemiologie Appliquee (Laboratory/Research/Testing facility). Phase: Therapeutic confirmatory (Phase III). Countries: France (ended).
Therapeutic area(s): Diseases [C] - Virus Diseases [C02]
Gender: Female, Male. Age: 18-64 years, 65+ years. Enrolment: 30.
Status: Ended. End date (EU): 2026-03-26. Decision date: 2024-09-19. Results received: No. Last updated: 2025-03-21.

Condition(s): HIV infection
Product: Vocabria 600 mg prolonged-release suspension for injection, Sunlenca 300 mg film-coated tablets, Sunlenca 464 mg solution for injection, Vocabria 30 mg film-coated tablets

Primary endpoint: Percentage of participants with virological failure at week 48: i.2 consecutive CVs ≥50 copies/mL after achieving a CV <50 copies/mL; or ii. a CV ≥50 copies/mL followed by definitive cessation of treatment or follow-up after achieving a CV <50 copies/mL; or iii. a viral load CV ≥50 copies/mL at week 48. For patients detectable at baseline, virological failure will be assessed from week 24.
Endpoint(s): Percentage of participants with virological failure between W24 and W48, Percentage of participants achieving therapeutic success at W48 (absence of virological failure and definitive discontinuation of assigned treatment or study continuation due to intolerance). Change of residence, change of treatment due to pregnancy, force majeure (inability to give an injection due to hospitalisation or travel abroad, etc.) and death unrelated to study treatment will not be considered as failures., Percentage of participants with viruses harbouring resistance mutations to the current treatment at the time of virological failure (by Sanger) and description of the resistance mutations selected at the time of virological failure., Proportion of minority resistance variants archived in DNA at D0 and their impact on the risk of virological failure and on the selection of resistance mutations., Describe the evolution of the proportion of intact and defective proviruses in PBMC at D0 and W48., Percentage of participants with at least one "blip" (viral load greater than 50 copies/mL with a control less than or equal to 50 copies/mL) between D0 and W48., Change in CD4 and CD8 T lymphocytes and CD4/CD8 ratio between W-2 and W48, Description of plasma concentrations of antiretroviral treatments between D0 and W48, Incidence of clinical and laboratory grade 3 or higher adverse events, Incidence of adverse events and discontinuation from study to W48, Changes in weight and BMI from D0 to W48, Metabolic parameters (total cholesterol, LDL-c, HDL-c, triglycerides and fasting plasma glucose) from D0 to W48, Change in participants' symptoms as assessed by self-report questionnaire from D0 to W48, Assessment of participant satisfaction by questionnaire between D0 and W48

Source: https://euclinicaltrials.eu/ctis-public/view/2024-516028-33-01